EU clinical trial 2023-506449-40-00: A Phase II, Randomized, Partially Blinded Study to Assess the Safety, Tolerability and Immunogenicity of Meningococcal Combined ABCWY Vaccine when Administered to Healthy Infants
Protocol code: 217043
Sponsor: GlaxoSmithKline Biologicals (Pharmaceutical company). Phase: Phase I and Phase II (Integrated)- Other. Countries: Poland (ended), Spain (ended), Germany (ended).
Therapeutic area(s): Diseases [C] - Bacterial Infections and Mycoses [C01]
Gender: Female, Male. Age: 0-17 years. Enrolment: 497.
Status: Ended. Start date (EU): 2021-11-29. End date (EU): 2025-11-21. End date: 2025-11-22. Decision date: 2024-01-19. Results received: Yes. Last updated: 2025-09-01.
Decision dates by country: DE: 2024-06-10, PL: 2024-02-29, ES: 2024-01-22

Condition(s): Infections, Meningococcal
Product: Nimenrix powder and solvent for solution for injection in pre-filled syringe Meningococcal groups A, C, W-135 and Y conjugate vaccine, Prevenar 13 suspension for injection pneumococcal polysaccharide conjugate vaccine (13-valent, adsorbed), Rotarix oral suspension in pre-filled oral applicator Rotavirus vaccine, live, Infanrix hexa, Powder and suspension for suspension for injection. Diphtheria (D), tetanus (T), pertussis (acellular, component) (Pa), hepatitis B (rDNA) (HBV), poliomyelitis (inactivated) (IPV) and Haemophilus influenzae type b (Hib) conjugate vaccine (adsorbed)., Bexsero suspension for injection in pre-filled syringe Meningococcal group B Vaccine (rDNA, component, adsorbed)

Primary endpoint: Number and percentage of participants with: -solicited administration site and systemic events during the 7 days (including the day of vaccination) after each vaccination. -any unsolicited adverse events (AEs), including medically attended adverse events (MAEs), serious adverse events (SAEs), AEs leading to withdrawal and adverse events of special interest (AESIs), during the 30 days after each vaccination. -MAEs, SAEs, AEs leading to withdrawal and AESIs throughout the study., Percentages of participants with human serum bactericidal assay (hSBA) titres ≥lower limit of quantitation (LLOQ) and the hSBA geometric mean titres (GMTs) for each A, C, W and Y serogroup and each serogroup B indicator strain at: -1 month after the second vaccination (Day 91) -pre-third vaccination (Day 301) -1 month after the third vaccination (Day 331) hSBA geometric mean ratios (GMRs) for each A, C, W and Y serogroup and B indicator strains at Day 331 compared to pre third vaccination

Source: https://euclinicaltrials.eu/ctis-public/view/2023-506449-40-00